EU clinical trial 2025-524894-17-00: A randomized double-masked, multicenter, 3-arm, pivotal Phase 2/3 study to evaluate the efficacy and safety of intravitreal (IVT) EYE201/MK-8748 compared to aflibercept (2 mg) in participants with neovascular age-related macular degeneration (NVAMD)
Protocol code: MK-8748-003
Sponsor: Eyebiotech Limited (Laboratory/Research/Testing facility). Phase: Phase II and Phase III (Integrated). Countries: Austria (authorised, recruitment pending), Slovakia (authorised, recruitment pending), Portugal (ongoing, recruiting), Czechia (ongoing, recruiting), Hungary (authorised, recruiting), Spain (ongoing, recruiting), France (ongoing, recruiting), Denmark (authorised, recruitment pending), Italy (authorised, recruiting), Croatia (authorised, recruitment pending).
Therapeutic area(s): Diseases [C] - Eye Diseases [C11]
Gender: Female, Male. Age: 18-64 years, 65+ years. Enrolment: 250.
Start date (EU): 2026-06-22. Decision date: 2026-06-05. Results received: No. Last updated: 2026-06-15.
Decision dates by country: PT: 2026-06-09, AT: 2026-06-08, HR: 2026-06-15, CZ: 2026-06-05, DK: 2026-06-08, FR: 2026-06-09, HU: 2026-06-11, IT: 2026-06-08, ES: 2026-06-05, SK: 2026-06-08

Condition(s): Neovascular age-related macular degeneration (NVAMD)
Product: FLUORESCEIN, AFLIBERCEPT

Primary endpoint: Mean change in best-corrected visual acuity (BCVA) (Early Treatment of Diabetic Retinopathy Study [ETDRS]) letter score from baseline to Year 1

Source: https://euclinicaltrials.eu/ctis-public/view/2025-524894-17-00